EU clinical trial 2023-508099-12-00: A Phase 3, randomized, double-blind, placebo-controlled, parallel-group, 3-arm, multinational, multicenter study to evaluate the efficacy and safety of amlitelimab by subcutaneous injection in participants aged 12 years and older with moderate-to-severe atopic dermatitis (AD) who are on background topical corticosteroids and have had an inadequate response to prior biologic therapy or oral Janus Kinase (JAK) inhibitor treatment - EFC17599 / AQUA
Protocol code: EFC17599 - AQUA
Sponsor: Sanofi-Aventis Recherche & Developpement (Pharmaceutical company). Phase: Therapeutic confirmatory (Phase III). Countries: Italy (ongoing, recruiting), Greece (ongoing, recruiting), Spain (ongoing, recruiting), Germany (ongoing, recruiting), Netherlands (ended), Poland (ongoing, recruiting), France (ongoing, recruiting).
Therapeutic area(s): Diseases [C] - Skin and Connective Tissue Diseases [C17]
Gender: Female, Male. Age: 0-17 years, 18-64 years, 65+ years. Enrolment: 143.
Start date (EU): 2024-06-20. Decision date: 2024-05-29. Results received: No. Last updated: 2026-08-05.
Decision dates by country: NL: 2024-06-03, FR: 2024-05-29, GR: 2024-06-03, PL: 2024-06-03, ES: 2024-05-30, DE: 2024-05-30, IT: 2024-05-31

Condition(s): Dermatitis atopic
Product: Amlitelimab, TACROLIMUS, Placebo, Amlitelimab, PIMECROLIMUS

Primary endpoint: EU, EU reference countries, and Japan: Proportion of participants with Validated Investigator Global Assessment scale for Atopic Dermatitis (vIGA-AD) of 0 (clear) or 1 (almost clear) and a reduction from baseline of ≥2 points at Week 36, EU, EU reference countries, and Japan: Proportion of participants reaching 75% reduction from baseline in Eczema Area and Severity Index (EASI) score (EASI 75) at Week 36, US and US reference countries: Proportion of participants with vIGA AD of 0 (clear) or 1 (almost clear) and a reduction from baseline of ≥2 points at Week 36
Endpoint(s): Proportion of participants reaching EASI-75 at Week 36 (for US and US reference countries only), Proportion of participants with vIGA-AD 0 (clear) or 1 (almost clear) with presence of only barely perceptible erythema (no induration/papulation, no lichenification, no oozing or crusting) and a reduction from baseline of ≥2 points, Proportion of participants with ≥4-point reduction in weekly average of daily Peak Pruritus-Numerical Rating Scale (PP-NRS) from baseline in participants with baseline weekly average of daily PP-NRS ≥4, Proportion of participants reaching EASI-75, Proportion of participants with vIGA-AD of 0 (clear) or 1 (almost clear) and a reduction from baseline of ≥2 points, Proportion of participants reaching EASI-90, Proportion of participants reaching EASI-100, Proportion of participants with PP-NRS ≤1, Change in Dermatology Life Quality Index (DLQI) from baseline in participants with age ≥16 years old, Proportion of participants with a reduction in DLQI ≥4 from baseline in participants with age ≥16 years old and with DLQI baseline ≥4, Change in Children Dermatology Life Quality Index (CDLQI) from baseline in participants with age ≥12 to <16 years, Proportion of participants with a reduction in CDLQI ≥6 from baseline in participants with age ≥12 to <16 years old and with CDLQI baseline ≥6, Change in Hospital Anxiety Depression Scale (HADS) from baseline, Proportion of participants with HADS subscale Anxiety (HADS-A) <8 in participants with baseline HADS-A ≥8, Proportion of participants with HADS subscale Depression (HADS-D) <8 in participants with HADS-D baseline ≥8, Absolute change in weekly average of daily Skin Pain-Numerical Rating Scale (SP-NRS) from baseline, Proportion of participants with a reduction in weekly average of daily SP-NRS ≥4 from baseline in participants with baseline weekly average of daily SP-NRS ≥4, Absolute change in weekly average of daily Sleep Disturbance-Numerical Rating Scale (SD-NRS) from baseline, Proportion of participants with a reduction in weekly average of daily SD-NRS ≥3 from baseline in participants with Baseline weekly average of daily SD-NRS ≥3, Percent change in EASI score from baseline, Percent change in weekly average of daily PP-NRS from baseline, Absolute change in weekly average of daily PP-NRS from baseline, Proportion of participants reaching EASI-50, Proportion of participants with EASI ≤7, Change in percent Body Surface Area (BSA) affected by AD from baseline, Percent change in Scoring Atopic Dermatitis (SCORAD) index from baseline, Absolute change in Scoring Atopic Dermatitis (SCORAD) index from baseline, Proportion of participants with a reduction in SCORAD ≥ 8.7 points from baseline in participants with baseline SCORAD score ≥ 8.7, Proportion of participants with a reduction in Patient Oriented Eczema Measure (POEM) ≥4 from baseline in participants with POEM Baseline ≥4, Change in POEM from baseline, Proportion of participants with rescue medication use, Time to onset of effect on PP-NRS as measured by proportion of participants with an improvement (reduction) in PP-NRS by ≥ 4, Percentage of TCS/TCI free days, Percentage of participants who experience Treatment-Emergent Adverse Events (TEAEs), experience Treatment-Emergent Serious Adverse Events (TESAEs) and/or Treatment-Emergent Adverse Events of Special Interest (AESI), Serum amlitelimab concentrations, Incidence of antidrug antibodies (ADAs) of amlitelimab, Time to onset of effect on vIGA-AD as measured by proportion of participants with vIGA-AD 0 (clear) or 1 (almost clear) and a reduction from baseline ≥2 during the 36-week treatment period, Time to onset of effect on EASI as measured by proportion of participants reaching a 75% reduction from baseline in EASI score during the 36-week treatment period, Percent change in weekly average of daily SP-NRS from baseline, Proportion of participants with vIGA-AD 0 (clear), Percent change in weekly average of daily SD-NRS

Source: https://euclinicaltrials.eu/ctis-public/view/2023-508099-12-00